EU clinical trial 2024-511035-10-00: A Phase 3, Open-Label, Parallel Group, Multicenter, Extension Study Evaluating the Long-Term Treatment of Bimekizumab in Study Participants With Moderate to Severe Hidradenitis Suppurativa
Protocol code: HS0005
Sponsor: UCB Biopharma (Pharmaceutical company). Phase: Therapeutic confirmatory (Phase III). Countries: Germany (ended), Ireland (ended), Greece (ended), Bulgaria (ended), Spain (ended), France (ended), Poland (ended), Netherlands (ended), Italy (ended).
Therapeutic area(s): Diseases [C] - Immune System Diseases [C20]
Gender: Female, Male. Age: 18-64 years, 65+ years. Enrolment: 347.
Status: Ended. Start date (EU): 2021-06-23. End date (EU): 2026-01-15. End date: 2026-07-22. Decision date: 2024-08-08. Results received: No. Last updated: 2026-01-08.
Decision dates by country: BG: 2024-08-08, GR: 2024-09-23, IE: 2024-08-08, ES: 2024-08-09, NL: 2024-08-12, PL: 2024-08-29, FR: 2024-08-14, IT: 2024-09-25, DE: 2024-08-15

Condition(s): Hidradenitis Suppurativa
Product: bimekizumab

Primary endpoint: Percentage of participants with treatment- emergent adverse events (TEAEs) during the study
Endpoint(s): Percentage of participants with treatment- emergent serious adverse events (SAEs) during the study, Percentage of participants with treatment-emergent adverse events (TEAEs) leading to withdrawal from the study, Percentage of participants achieving clinical response as measured by Hidradenitis Suppurativa Clinical Response 50 (HiSCR50), Percentage of participants achieving clinical response as measured by Hidradenitis Suppurativa Clinical Response 75 (HiSCR75), Percentage of participants with Flare, Hidradenitis Suppurativa Symptom Questionnaire (HSSQ) Response for Skin Pain, Absolute change from Baseline in Dermatology Life Quality Index (DLQI) Total Score

Source: https://euclinicaltrials.eu/ctis-public/view/2024-511035-10-00